EU clinical trial 2024-514924-17-00: A Phase I/II Study in Healthy Subjects to Evaluate the Safety, Tolerability, and Imaging Quality of Single Ascending IV Doses of HarMono-T Contrast Agent During Ultrasound of the Kidney
Protocol code: CTSP-001
Sponsor: Solstice Pharmaceuticals B.V. (Pharmaceutical company). Phase: Phase I and Phase II (Integrated)- Other. Countries: Germany (not authorised).
Therapeutic area(s): Analytical, Diagnostic and Therapeutic Techniques and Equipment [E] - Diagnosis [E01]
Gender: Female, Male. Age: 18-64 years. Enrolment: 20.
Status: Not authorised. Decision date: 2025-08-12. Results received: No. Last updated: 2025-08-12.

Condition(s): Ultrasound contrast agent, for diagnostic purposes (to assess indeterminate kidney lesions)
Product: HarMono-T 5 microlitres/mL gas and solvent for dispersion for injection/infusion

Primary endpoint: The occurrence of adverse reactions until 7±2days post injection, 12-lead ECG, Vital signs, Clinical laboratory parameters (haematology; renal and hepatic functions)
Endpoint(s): Parametric imaging (Time to Peak (s), Peak Enhance-ment (dB)), Parametric imaging (Wash-in Area Under the Curve (dB), Wash-out Area Under the Curve (dB)), Parametric imaging (Peak Enhancement (dB)), CEUS at 30minutes post dose is to confirm total clearing of HarMono-T

Source: https://euclinicaltrials.eu/ctis-public/view/2024-514924-17-00